EU clinical trial 2024-513871-42-00: Oral laxatives after hip fracture surgery: A randomised controlled trial
Sponsor: Odense University Hospital (Hospital/Clinic/Other health care facility). Phase: Therapeutic use (Phase IV). Countries: Denmark (ended).
Therapeutic area(s): Phenomena and Processes [G] - Musculoskeletal and Neural Physiological Phenomena [G11]
Gender: Female, Male. Age: 65+ years. Enrolment: 375.
Status: Ended. Start date (EU): 2024-10-01. End date (EU): 2026-08-01. Decision date: 2024-07-04. Results received: No. Last updated: 2025-07-08.

Condition(s): Hip fracture
Product: MACROGOL, COMBINATIONS, BISACODYL

Primary endpoint: The proportion of patients in each group who needs recue medication after 72 hours or rescue medication before 72 hours on behalf of a medical assessment

Source: https://euclinicaltrials.eu/ctis-public/view/2024-513871-42-00